EU clinical trial 2022-500221-33-01: A Phase 3, single-arm, multicenter, multinational, open-label, one-way crossover study to investigate the efficacy and safety of fitusiran prophylaxis in male participants aged ≥ 12 years with severe hemophilia A or B with or without inhibitory antibodies to factor VIII or IX
Protocol code: EFC17574 (ATLAS-NEO)
Sponsor: Sanofi-Aventis Recherche & Developpement (Pharmaceutical company). Phase: Therapeutic confirmatory (Phase III). Countries: France (ongoing, recruitment ended), Poland (ongoing, recruitment ended), Greece (ongoing, recruitment ended), Spain (ongoing, recruitment ended), Germany (ongoing, recruitment ended), Italy (ongoing, recruitment ended).
Therapeutic area(s): Diseases [C] - Congenital, Hereditary, and Neonatal Diseases and Abnormalities [C16]
Gender: Male. Age: 0-17 years, 18-64 years, 65+ years. Enrolment: 17.
Status: Ongoing, recruitment ended. Start date (EU): 2023-07-28. Decision date: 2023-06-20. Results received: No. Last updated: 2026-06-15.
Decision dates by country: ES: 2023-06-23, GR: 2023-06-21, DE: 2023-06-20, FR: 2023-06-26, IT: 2023-06-22, PL: 2023-06-26

Condition(s): Hemophilia
Product: COAGULATION FACTOR IX, ANTITHROMBIN III, SAR439774, COAGULATION FACTOR VIII, FACTOR VIII INHIBITOR BYPASSING ACTIVITY, EPTACOG ALFA (ACTIVATED)

Primary endpoint: Annualized Bleeding Rate (ABR) in the fitusiran primary efficacy period
Endpoint(s): Annualized bleeding rate (ABR) while on fitusiran prophylaxis in the fitusiran primary efficacy period and ABR while on prophylaxis standard of care (SOC) in the SOC period, Annualized bleeding rate (ABR) while on fitusiran prophylaxis in the fitusiran primary efficacy period and ABR while on on-demand standard of care (SOC) in the SOC period, Annualized spontaneous bleeding rate in the fitusiran primary efficacy period and in the SOC period, Annualized joint bleeding rate in the fitusiran primary efficacy period and in the SOC period, Change in Haem-A-QOL physical health score and total score during SOC and during fitusiran prophylaxis, Annualized bleeding rate (ABR) in the fitusiran 18-month efficacy period, Annualized bleeding rate (ABR) in the fitusiran 36-month treatment period, Annualized weight-adjusted consumption of CFC/BPA, Number of participants with adverse events

Source: https://euclinicaltrials.eu/ctis-public/view/2022-500221-33-01